EU clinical trial 2022-501005-12-00: A PHASE 3, MULTICENTER, RANDOMIZED, DOUBLE-BLIND, PLACEBO-CONTROLLED STUDY, WITH A SAFETY AND DOSE CONFIRMATION RUN-IN PERIOD, TO EVALUATE THE EFFICACY AND SAFETY OF OBEXELIMAB IN PATIENTS WITH WARM AUTOIMMUNE HEMOLYTIC ANEMIA (SAPHIARE)
Protocol code: ZB012-03-002
Sponsor: Zenas Biopharma (USA) LLC (Pharmaceutical company). Phase: Therapeutic confirmatory (Phase III). Countries: Spain (ended), Italy (ended), Poland (ended).
Therapeutic area(s): Diseases [C] - Immune System Diseases [C20]
Gender: Female, Male. Age: 18-64 years, 65+ years. Enrolment: 14.
Status: Ended. Start date (EU): 2023-09-22. End date (EU): 2025-08-27. End date: 2025-08-28. Decision date: 2023-07-19. Results received: No. Last updated: 2025-04-15.
Decision dates by country: PL: 2023-08-29, ES: 2023-07-24, IT: 2023-07-19

Condition(s): WARM AUTOIMMUNE HEMOLYTIC ANEMIA
Product: Obexelimab, Placebo sterile solution for SC injection

Primary endpoint: Incidence of AEs, SAEs, and any AESIs, as defined by the CTCAE v5.0, Proportion of patients with Hgb ≥ 10 g/dL and ≥ 2 g/dL increase from Baseline on or after Week 8 with no use of blood transfusion or GC rescue therapy prior to attaining response, Proportion of patients who achieve a durable Hgb response (defined as Hgb ≥ 10 g/dL and ≥ 2 g/dL increase from Baseline on at least 3 of 4 consecutive available visits), at the earliest on or after Week 12, with no use of blood transfusion or GC rescue therapy prior to attaining durable response through Week 24, Incidence of AEs, SAEs, and any AESIs, as defined by the CTCAE v5.0, Proportion of patients with Hgb ≥ 10 g/dL and ≥ 2 g/dL increase from Baseline, with no use of blood transfusion or GC rescue therapy, Time in Hgb response in patients achieving durable Hgb response, Cumulative dose of GC rescue therapy
Endpoint(s): Change from Baseline in FACIT-F score through Week 24, Proportion of patients with no use of blood transfusion or GC rescue therapy through Week 24, Proportion of patients who achieve a durable Hgb response (defined as Hgb ≥ 10 g/dL and ≥ 2 g/dL increase from Baseline on at least 3 of 4 consecutive available visits) at the earliest on, or after Week 8, with no use of blood transfusion or GC rescue therapy prior to attaining durable response through Week 24, Proportion of patients who attain normal values on or after Week 8 with no use of blood transfusion or GC rescue therapy prior to response: – Lactate dehydrogenase (LDH) – Haptoglobin – Indirect bilirubin, Change from Baseline to Week 24 in Hgb concentration, Time to Hgb ≥ 10 g/dL and ≥ 2 g/dL increase from Baseline, with no use of blood transfusion or GC rescue therapy, Proportion of patients with no use of blood transfusions through Week 24, Obexelimab serum concentrations through Week 24, Incidence of anti-obexelimab antibodies through Week 24, "Change from Baseline through Week 24 over time in the following: – Circulating absolute T, B, and NK cell count – Ig levels and ratios (e.g., IgG, IgM, IgA, IgE) – CD19 target receptor occupancy – Reticulocyte count – LDH – Haptoglobin – Indirect bilirubin", Change from Baseline to Week 24 in FACIT-F Score, Proportion of patients with no use of blood transfusion or GC rescue therapy through Week 24, Cumulative dose of GC rescue therapy through Week 24, Proportion of patients with no use of blood transfusions through Week 24, Change from Baseline to Week 24 in Hgb concentration, "Proportion of patients who attain normal values on at least 3 of 4 consecutive available visits, at the earliest on or after Week 12, with no use of blood transfusion or GC rescue therapy prior to attaining durable response through Week 24 in all 3 of the following: – LDH – Haptoglobin – Indirect bilirubin", Proportion of patients with a ≥ 3-point increase in FACIT-F score at Week 24, with no prior use of blood transfusion or GC rescue therapy, Time to durable Hgb response, in patients who achieve the primary endpoint, Percentage of time in Hgb response, on or after Week 4 through Week 24, in patients who achieve the primary endpoint, Incidence of AEs, SAEs, and any AESIs, as defined by the CTCAE v5.0

Source: https://euclinicaltrials.eu/ctis-public/view/2022-501005-12-00